EU clinical trial 2024-519478-38-00: A study investigating the safety, absorption, and elimination of NNC0705-0001, a new compound that could potentially be used in the treatment of cardiometabolic diseases caused by inflammation.
Protocol code: NN6705-8141
Sponsor: Novo Nordisk A/S (Pharmaceutical company). Phase: Human Pharmacology (Phase I)- First administration to humans. Countries: Netherlands (ended).
Therapeutic area(s): Diseases [C] - Cardiovascular Diseases [C14]
Gender: Female, Male. Age: 18-64 years. Enrolment: 116.
Status: Ended. Start date (EU): 2025-06-03. End date (EU): 2025-12-10. Decision date: 2025-05-30. Results received: No. Last updated: 2025-05-30.

Condition(s): Cardiometabolic diseases with an inflammatory component

Source: https://euclinicaltrials.eu/ctis-public/view/2024-519478-38-00